EU clinical trial 2023-509266-38-00: A study evaluating the safety, tolerability, pharmacokinetics, and activity of RO7566802 given alone and in combination with atezolizumab in patients with locally advanced or metastatic solid tumor malignancies
Protocol code: GO44431
Sponsor: Genentech Inc. (Pharmaceutical company). Phase: Human Pharmacology (Phase I)- First administration to humans. Countries: Spain (ended), Czechia (ended).
Therapeutic area(s): Diseases [C] - Neoplasms [C04]
Gender: Female, Male. Age: 18-64 years, 65+ years. Enrolment: 23.
Status: Ended. End date (EU): 2026-06-12. Decision date: 2025-02-18. Results received: No. Last updated: 2026-03-30.
Decision dates by country: ES: 2025-02-18, CZ: 2025-02-24

Condition(s): Locally Advanced or Metastatic Solid Tumors

Source: https://euclinicaltrials.eu/ctis-public/view/2023-509266-38-00